EU clinical trial 2023-507222-17-00: A Randomized, Open Label Phase 3 Study Evaluating Safety and Efficacy of Venetoclax in combination with Azacitidine after allogeneic Stem Cell Transplantation in Subjects with Acute Myeloid Leukemia (AML) (VIALE-T)
Protocol code: M19-063
Sponsor: AbbVie Deutschland GmbH & Co. KG (Pharmaceutical company). Phase: Therapeutic confirmatory (Phase III). Countries: Czechia (ended), Hungary (ended), Spain (ended), Italy (ended), Germany (ended), Greece (ended), France (ended).
Therapeutic area(s): Diseases [C] - Neoplasms [C04]
Gender: Female, Male. Age: 0-17 years, 18-64 years, 65+ years. Enrolment: 120.
Status: Ended. Start date (EU): 2020-07-24. End date (EU): 2025-09-02. End date: 2025-09-23. Decision date: 2024-01-09. Results received: Yes. Last updated: 2025-08-26.
Decision dates by country: GR: 2024-04-01, IT: 2024-01-11, CZ: 2024-01-09, HU: 2024-01-09, FR: 2024-01-19, ES: 2024-01-10, DE: 2024-01-10

Condition(s): Acute Myeloid Leukaemia
Product: AZACITIDINE, Venetoclax, Venetoclax, Venetoclax

Primary endpoint: Part I: The primary endpoint is the frequency of DLTs of venetoclax in combination with azacitidine, Part II: OS defined as the time from randomization to death from any cause
Endpoint(s): IRC-assessed morphologic RFS, IRC-assessed composite relapse-free survival, GvHD-free, relapse free survival (GRFS), GvHD rate at 90 days after randomization (Arm B) or initiation of treatment (Arm A). "Higher grade GvHD" is defined as Grade 2 or higher for aGvHD and moderate or severe for cGvHD as defined by the investigator following National Institutes of Health (NIH) criteria., Change from baseline (Cycle 1 Day 1 [predose]) at 6 months in physical functioning after randomization (Arm B) or initiation of study treatment (Arm A) in adult subjects, as measured by the EORTC QLQ-C30 physical functioning domain, Fatigue Change from baseline at 6 months after randomization (Arm B) or initiation of study treatment (Arm A) in adult subjects –defined as Fatigue measured as Patient Reported Outcome (PRO) using Patient Reported Outcomes Measurement Information System (PROMIS) Cancer Fatigue SF 7a, Measurable residual disease conversion rate –The rate will be calculated only among subjects with MRD ≥10–3 at baseline (Cycle 1 Day 1 [predose]). The MRD conversion rate will be defined as proportion of subjects who convert to MRD < 10–3 after randomization (Arm B) or initiation of treatment (Arm A), Time to deterioration in Global Health Status (GHS)/QoL in adult subjects - defined as time from randomization to death from any cause, or the first-time deterioration of ≥10 points from baseline (Cycle 1 Day 1 [predose]) in GHS/QoL score as measured by the European Organization for Research and Treatment of Cancer Quality of Life Questionnaire (EORTC QLQ-C30) Version 3, whichever occurs first

Source: https://euclinicaltrials.eu/ctis-public/view/2023-507222-17-00